EU clinical trial 2023-507795-51-00: Obicetrapib and Cardiovascular Outcomes: A Placebo-Controlled, Double-Blind, Randomized Phase 3 Study to Evaluate the Effect of 10 mg Obicetrapib in Participants With Atherosclerotic Cardiovascular Disease (ASCVD) Who are Not Adequately Controlled Despite Maximally Tolerated Lipid-Modifying Therapies
Protocol code: TA-8995-304
Sponsor: NewAmsterdam Pharma B.V. (Pharmaceutical company). Phase: Therapeutic confirmatory (Phase III). Countries: Spain (ongoing, recruitment ended), Netherlands (ongoing, recruitment ended), Latvia (ongoing, recruitment ended), Finland (ongoing, recruitment ended), Hungary (ongoing, recruitment ended), Slovakia (ongoing, recruitment ended), Germany (ongoing, recruitment ended), Denmark (ongoing, recruitment ended), Italy (ongoing, recruitment ended), Bulgaria (ongoing, recruitment ended), Czechia (ongoing, recruitment ended), Croatia (ongoing, recruitment ended), Poland (ongoing, recruitment ended).
Therapeutic area(s): Diseases [C] - Cardiovascular Diseases [C14]
Gender: Female, Male. Age: 18-64 years, 65+ years. Enrolment: 4094.
Status: Ongoing, recruitment ended. Start date (EU): 2022-05-17. Decision date: 2023-10-05. Results received: No. Last updated: 2026-08-03.
Decision dates by country: DE: 2023-10-12, NL: 2023-10-05, LV: 2023-10-17, IT: 2023-10-25, SK: 2023-10-06, DK: 2023-10-10, BG: 2023-11-01, ES: 2023-10-05, PL: 2023-12-07, HU: 2023-10-06, FI: 2023-10-06, CZ: 2023-10-24, HR: 2023-10-27

Condition(s): atherosclerotic heart and blood vessel disease (the narrowing of arteries from buildup of plague
Product: Obicetrapib, The pharmaceutical form of the placebo drug product is a 6 mm diameter, white, film-coated, round, biconvex tablet with no identifying markings, matching the appearance of obicetrapib 5 mg and 10 mg tablets. the placebo to match obcietrapib tablets contain the same qualitative excipient blend as used in the corresponding active tablets but with additional microcrystalline cellulose replacing the obicetrapib drug substance

Primary endpoint: the time from Randomization to the first confirmed occurrence of any component of the composite endpoint, including the following (MACE-4): - CHD death; - Non-fatal MI; - Fatal or Non-fatal ischemic stroke; or - Any coronary revascularization.
Endpoint(s): 1) The time from Randomization until the first confirmed occurrence of a composite of CHD death, non fatal MI, or fatal or non-fatal ischemic stroke (MACE-3);, 2) The total occurrences after Randomization of CHD death, non fatal MI, fatal or non fatal ischemic stroke, and any coronary revascularization;, 3) The time from Randomization until the first confirmed occurrence of a composite of CHD death, non-fatal MI, or any coronary revascularization;, 4) The time from Randomization until the first confirmed occurrence of a composite of CV death, non-fatal MI, non-fatal ischemic stroke, or non-elective coronary revascularization;, 5) The time from Randomization until the first confirmed occurrence of a composite of all-cause death, non-fatal MI, non-fatal ischemic stroke, or non-elective coronary revascularization;, 6) The time from Randomization until the first confirmed occurrence of a composite of CHD death, non-fatal MI, fatal or non-fatal ischemic stroke, any coronary revascularization, or MALE;

Source: https://euclinicaltrials.eu/ctis-public/view/2023-507795-51-00